EU clinical trial 2022-501147-32-00: A Phase 2/3, Multicenter, Randomized, Active-Controlled, Open-label Study to Evaluate the Efficacy and Safety of Zanubrutinib in Patients With Primary Membranous Nephropathy
Protocol code: BGB-3111-309
Sponsor: BeOne Medicines AG (Pharmaceutical company). Phase: Phase II and Phase III (Integrated). Countries: Spain (ended), Poland (ended), Czechia (ongoing, recruitment ended), Italy (ongoing, recruitment ended).
Therapeutic area(s): Diseases [C] - Immune System Diseases [C20]
Gender: Female, Male. Age: 18-64 years, 65+ years. Enrolment: 21.
Start date (EU): 2024-07-11. Decision date: 2023-09-07. Results received: No. Last updated: 2026-02-17.
Decision dates by country: ES: 2023-09-07, PL: 2023-09-11, CZ: 2023-09-07, IT: 2023-09-08

Condition(s): Primary Membranous Nephropathy
Product: Zanubrutinib, TACROLIMUS

Primary endpoint: Part 1: The primary endpoint is change from baseline in urine protein creatinine ratio (UPCR) at Week 24., Part 2: The primary endpoint is complete remission status (Yes/No) (for definition of complete remission, refer to Section 8.2.1 of the protocol) at Week 104.
Endpoint(s): Part 1: Treatment failure status (Yes/No) by Week 24, Part 1: Immunological response status (Yes/No) at Week 24, Part 1: Complete remission status (Yes/No) at Week 24, Week 52, Week 76, and Week 104, Part 1: Overall remission status (Yes/No) at Week 24, Week 52, Week 76, and Week 104, Part 1: Relapse status (Yes/No) by Week 104, Part 1: Incidence and severity of treatment-emergent adverse events, Part 2: overall remission status (Yes/No) (for definition of overall remission, refer to Section 8.2.3 of the protocol) at Week 104., Part 2: Complete remission status (Yes/No) at Week 24, Week 52, and Week 76, Part 2: Overall remission status (Yes/No) at Week24, Week 52, and Week 76, Part 2: Treatment failure status (Yes/No) by Week 24, Week 52, Week 76, and Week 104, Part 2: Time to first complete remission: the time from the date of randomization to the date of the first complete remission, Part 2: Time to first overall remission: the time from the date of randomization to the date of the first overall remission, Part 2: Relapse status (Yes/No) by Week 104, Part 2: Time to first relapse: the time from the date of first complete or partial remission to the date of the first relapse, Part 2: Patient-reported symptoms and overall health status as measured using the Kidney Disease and Quality of Life instrument™ - 36 items (KDQoL-36) and European Quality of Life 5-Dimensions 5-Levels Health Questionnaire (EQ-5D- 5L), Part 2: ≥ 30% eGFR reduction from baseline to Week 52 and Week 104 (Yes/No), Part 2: Incidence and severity of treatment-emergent adverse events

Source: https://euclinicaltrials.eu/ctis-public/view/2022-501147-32-00